EU clinical trial 2024-512469-15-00: A Phase 1/2, Multicenter, Open-Label, Single Arm, Dose Escalation and Expansion Study of Gilteritinib (ASP2215) Combined with Chemotherapy in Children, Adolescents and Young Adults with FMS-like Tyrosine Kinase 3 (FLT3)/Internal Tandem Duplication (ITD) Positive Relapsed or Refractory Acute Myeloid Leukemia (AML)
Protocol code: 2215-CL-0603
Sponsor: Astellas Pharma Global Development Inc. (Pharmaceutical company). Phase: Phase I and Phase II (Integrated)- Other. Countries: Spain (ended), Italy (ended), France (ended), Germany (ended).
Therapeutic area(s): Diseases [C] - Neoplasms [C04]
Gender: Female, Male. Age: 0-17 years, 18-64 years. Enrolment: 45.
Status: Ended. Start date (EU): 2020-12-08. End date (EU): 2025-03-17. End date: 2025-03-18. Decision date: 2024-05-23. Results received: Yes. Last updated: 2025-03-04.
Decision dates by country: FR: 2024-05-29, IT: 2024-06-10, ES: 2024-05-23, DE: 2024-05-23

Condition(s): FMS-like Tyrosine Kinase 3 (FLT3)/Internal Tandem Duplication (ITD) Positive Relapsed or Refractory Acute Myeloid Leukemia (AML)
Product: Zarzio 30 MU/0.5 ml solution for injection or infusion in pre-filled syringe, Gilteritinib, ARA-cell® 40 mg Injektion 20 mg/ml Injektionslösung / Konzentrat zur Herstellung einer Infusionslösung, Gilteritinib, Bendarabin 50 mg Pulver zur Herstellung einer Injektions- oder Infusionslösung, Citarabina Hikma 1 g/10mL Soluzione Iniettabile

Primary endpoint: • Phase 1: Determination of MTD and/or RP2D • Phase 2: o CRc rates (overall best response) after 2 cycles of therapy. o CR rates after 2 cycles of therapy; CR rate will be further described by the duration of CR (only for USA).
Endpoint(s): Inhibition of phosphorylated FLT3 (pFLT3) measured by PIA assay, Gilteritinib plasma concentration, Pharmacokinetic parameters (e.g., oral clearance [CL/F], apparent volume of distribution [Vd/F], maximum concentration [Cmax], time of maximum concentration [tmax], area under the concentration-time curve [AUC]) of gilteritinib, Safety, tolerability and toxicity assessments of gilteritinib when given in combination with FLAG, EFS rate, OS rate, MRD assessment, Acceptability and palatability assessment of the formulation

Source: https://euclinicaltrials.eu/ctis-public/view/2024-512469-15-00